EU clinical trial 2023-510214-11-00: Individualized Systems Medicine strategy to target cancer stem cells in patients with recurrent Glioblastoma (ISM-GBM)
Protocol code: ISM-GBM
Sponsor: Oslo University Hospital HF (Hospital/Clinic/Other health care facility). Phase: Human Pharmacology (Phase I)- Other. Countries: Norway (ongoing, recruiting).
Therapeutic area(s): Diseases [C] - Neoplasms [C04]
Gender: Female, Male. Age: 18-64 years, 65+ years. Enrolment: 15.
Status: Ongoing, recruiting. Start date (EU): 2023-03-21. Decision date: 2024-10-22. Results received: No. Last updated: 2026-02-23.

Condition(s): Recurrent Glioblastoma
Product: Gemcitabine Accord 100 mg/ml konsentrat til infusjonsvæske

Primary endpoint: Ability to perform drug-screen and select possible treatment strategy
Endpoint(s): Tumor volume ccording to response assessment in neuro-oncology (RANO) criteria, Adverse events induced by selected treatments, Overall survival in treated patients, Comparsion of drug response to individual molecular fingerprint of drug selectivity.

Source: https://euclinicaltrials.eu/ctis-public/view/2023-510214-11-00